EU clinical trial 2023-506159-12-00: ARGX-113-2207: An Open-label, Uncontrolled Study to Evaluate the Pharmacokinetics, Pharmacodynamics, Safety, and Activity of Efgartigimod PH20 SC in Participants From 2 to Less Than 18 Years of Age With Generalized Myasthenia Gravis
Protocol code: ARGX-113-2207
Sponsor: Argenx (Pharmaceutical company). Phase: Phase II and Phase III (Integrated). Countries: France (ongoing, recruiting), Germany (ongoing, recruiting), Spain (ongoing, recruiting), Netherlands (authorised, recruiting), Poland (ongoing, recruiting), Italy (ongoing, recruiting), Belgium (ongoing, recruiting), Czechia (authorised, recruiting).
Therapeutic area(s): Diseases [C] - Immune System Diseases [C20]
Gender: Female, Male. Age: 0-17 years. Enrolment: 8.
Start date (EU): 2024-09-06. Decision date: 2024-07-26. Results received: No. Last updated: 2026-07-29.
Decision dates by country: IT: 2024-07-29, CZ: 2025-03-06, ES: 2024-07-26, DE: 2024-07-29, BE: 2024-07-26, PL: 2024-07-30, FR: 2024-07-26, NL: 2024-07-31

Condition(s): Generalized Myasthenia Gravis
Product: Vyvgart 1 000 mg solution for injection

Primary endpoint: Efgartigimod serum concentrations as input for compartmental, model-driven analysis to determine age and size dependency of CL and Vd 2. PD parameters: total IgG levels and AChR-Ab as input for PK/PD modeling analysis
Endpoint(s): Incidence and severity of adverse events (AEs), including serious AEs and AEs of special interest • Changes in vital signs, electrocardiogram (ECGs), and clinical laboratory tests • Efgartigimod serum concentrations • Total IgG and AChR-Ab levels: absolute values, changes from baseline values, and percent (%) reductions from baseline values", Prevalence and incidence of antidrug antibodies (ADA) against efgartigimod and antibodies against rHuPH20 • Myasthenia Gravis Activities of Daily Living (MG-ADL) total score: absolute value and change from baseline appropriate for pediatric use • Quantitative Myasthenia Gravis (QMG): absolute value and change from baseline ", EQ-5D-Y: absolute value and change from baseline • Quality of Life in Neurological Disorders Questionnaire (Neuro-QoL) Pediatric Fatigue Score: change from baseline • Clinical Global Impression of Improvement (CGI-I): change from baseline • Changes in protective antibody titers to vaccines

Source: https://euclinicaltrials.eu/ctis-public/view/2023-506159-12-00